EU clinical trial 2025-522184-15-00: An Open-label, Phase I/II First in Human, Dose Escalation, Optimisation and Expansion Study to Evaluate the Safety, Tolerability, Pharmacokinetics, Pharmacodynamics, Immunogenicity and Anti-tumour Activity of IPN01203 in Participants With Locally Advanced or Metastatic Solid Tumours Who Have Progressed on or After Immune Checkpoint Inhibitor Therapies
Protocol code: CLIN-01203-450
Sponsor: Ipsen Pharma (Pharmaceutical company). Phase: Phase I and Phase II (Integrated)- First administration to humans. Countries: Spain (ongoing, recruiting), France (ongoing, recruiting).
Therapeutic area(s): Diseases [C] - Neoplasms [C04]
Gender: Female, Male. Age: 18-64 years, 65+ years. Enrolment: 38.
Status: Ongoing, recruiting. Start date (EU): 2026-02-18. Decision date: 2025-12-16. Results received: No. Last updated: 2026-08-06.
Decision dates by country: FR: 2026-02-05, ES: 2025-12-16

Condition(s): Advanced Solid Tumor, Metastatic Solid Tumor
Product: IPN01203

Primary endpoint: Ph Ia 1. Percentage of participants with dose limiting toxicity (DLT), 2. Percentage of participants experiencing treatment emergent adverse events (TEAEs) and treatment emergent serious adverse events (TE SAEs), Ph Ib 3. objective response rate (ORR) Defined as the percentage of participants with best overall response (BOR) of complete response (CR) or paritial response (PR), as determined by investigator per RECIST version 1.1
Endpoint(s): Ph Ia 1.Time to maximum observed drug concentration (Tmax) after single and multiple doses of IPN01203, 2. Maximum observed drug concentration (Cmax) after single and multiple doses of IPN01203, 3. Area under the plasma concentration time curve (AUCtau) after single and multiple doses of IPN01203, 4. Percentage of Treatment-Emergent Anti-Drug Antibodies (TEADA), Including Binding and Neutralizing Antibodies, 5. Objective response rate (ORR), 6. Ph Ib Duration of response (DoR). DoR is defined as the time from first documented evidence of CR or PR until progressive disease, as determined by investigator per RECIST version 1.1, or death from any cause, whichever occurs first, 7. Duration of stable disease (SD). SD is defined as the time from the date of first IPN01203 administration to the date of the first documented disease progression, as determined by investigator per RECIST version 1.1, or death due to any cause, whichever occurs first, for participants with SD as best response, with a minimum SD duration of 8 weeks, 8. Progression-free survival (PFS). PFS is defined as the time from the date of first IPN01203 administration to the date of the first documented disease progression, as determined by investigator per RECIST version 1.1, or death due to any cause, whichever occurs first., 9. Disease control rate (DCR). DCR is defined as the percentage of participants with BOR of CR, PR, or SD, as determined by investigator per RECIST version 1.1, from the first IPN01203 administration throughout the study., 10. Time to response (TTR). TTR is defined as the time between date of start of treatment until first documented response (CR or PR), as determined by investigator per RECIST version 1.1., 11. Percentage of Treatment-Emergent Anti-Drug Antibodies (TEADA), Including Binding and Neutralizing Antibodies

Source: https://euclinicaltrials.eu/ctis-public/view/2025-522184-15-00